EU clinical trial 2023-503315-15-00: (22138) A randomized, double-blind, placebo-controlled, multi-center study to assess the efficacy and safety of BAY 3018250 in patients with symptomatic proximal deep vein thrombosis
Protocol code: 22138
Sponsor: Bayer AG (Pharmaceutical company). Phase: Therapeutic exploratory (Phase II). Countries: Germany (ended), France (ended), Belgium (ended), Italy (ended), Netherlands (ended), Greece (ended), Bulgaria (ended), Czechia (ended), Hungary (ended), Spain (ended), Slovakia (ended).
Therapeutic area(s): Diseases [C] - Cardiovascular Diseases [C14]
Gender: Female, Male. Age: 18-64 years, 65+ years. Enrolment: 443.
Status: Ended. Start date (EU): 2023-12-20. End date (EU): 2025-12-02. End date: 2025-12-03. Decision date: 2023-11-02. Results received: No. Last updated: 2025-11-18.
Decision dates by country: GR: 2024-11-01, BG: 2024-10-28, ES: 2024-10-31, SK: 2024-10-31, BE: 2023-11-06, DE: 2023-11-02, IT: 2023-11-13, NL: 2023-11-13, HU: 2024-12-18, FR: 2023-11-03, CZ: 2024-10-24

Condition(s): Thrombolysis of symptomatic proximal vein thrombosis
Product: Placebo solution for BAY 3018250 solution, BAY 3018250

Primary endpoint: Area under the curve AUCn(6h-30d) of the ratio to baseline of clot burden, as assessed by repeated quantitative ultrasound at 6h, 24h, Day 7 and Day 30, Number of participants with composite of major and clinically relevant non-major (CRNM) bleeding events (ISTH definition) up to Day 15
Endpoint(s): Ratio to baseline of clot burden, as assessed by repeated quantitative ultrasound at 6h, 24h, Day 7, Day 30 and Day 90, respectively., Change from baseline in leg pain severity at 6h, 24h, Day 7, Day 30 and Day 90 (Likert pain scale), Change from baseline in post- venous thromboembolism functional status (PVFS) scale at Day 7, Day 30 and Day 90, Number participants with recurrent venous thromboembolism (VTE) up to Day 90

Source: https://euclinicaltrials.eu/ctis-public/view/2023-503315-15-00